EU clinical trial 2024-514684-26-00: Double-blind, randomized, placebo-controlled study of Leriglitazone in pediatric Rett Syndrome
Protocol code: MT-2-04
Sponsor: Minoryx Therapeutics S.L. (Pharmaceutical company). Phase: Therapeutic exploratory (Phase II). Countries: Spain (ongoing, recruitment ended).
Therapeutic area(s): Diseases [C] - Congenital, Hereditary, and Neonatal Diseases and Abnormalities [C16]
Gender: Female. Age: 0-17 years. Enrolment: 24.
Status: Ongoing, recruitment ended. Start date (EU): 2024-10-29. Decision date: 2024-10-08. Results received: No. Last updated: 2026-07-09.

Condition(s): Rett Syndrome
Product: The min-102 placebo is supplied as an oral suspension with similar appearance to min-102 drug product. min-102 placebo oral suspension is packaged in an amber glass bottle with filled volume based on the required clinical dose

Primary endpoint: Safety and tolerability will be assessed informally based on summary statistics calculated for TEAEs, SAEs and other safety assessments and considerations
Endpoint(s): Change from baseline in Rett Syndrome Behavior Questionnaire (RSBQ), total score and each subscore., Change from baseline in Vineland Adaptative Behavior Scale (VABS), total score., Change from baseline in Rett Syndrome Motor Evaluation Scale (RESMES), total score., Change from baseline in Communication and Symbolic Behaviour Scales - Developmental Profile - Infant Toddler (CSBS-DP-IT), total score., Change from baseline in Mac Arthur I and II (reported according to age group), total score., Change from baseline in Clinical Global Impression-Severity (CGI-S), total score., Change from baseline in Clinical Global Impression-Improvement (CGI-I), total score., Change from baseline in Rett Syndrome Caregiver Burden Inventory (RTT-CBI), total score., Number of seizures per week recorded in the diary., Number of apnea episodes per week recorded in the diary., Number of hyperventilation episodes per week recorded in the diary., Predicted area under the plasma concentration versus time curve (AUC) and maximum observed plasma concentration (Cmax) for leriglitazone., Minimum observed plasma concentration (Cmin) for leriglitazone and M3., Metabolic ratio.

Source: https://euclinicaltrials.eu/ctis-public/view/2024-514684-26-00